EU clinical trial 2024-513647-86-00: PIMOC - Personalized targeted therapies in inflammatory complex multi organ disease
Protocol code: P160906J
Sponsor: Assistance Publique Hopitaux De Paris (Hospital/Clinic/Other health care facility). Phase: Therapeutic exploratory (Phase II). Countries: France (ended).
Therapeutic area(s): Diseases [C] - Immune System Diseases [C20]; Diseases [C] - Skin and Connective Tissue Diseases [C17]
Gender: Female, Male. Age: 18-64 years, 65+ years. Enrolment: 32.
Status: Ended. Start date (EU): 2024-09-09. End date (EU): 2025-11-20. Decision date: 2024-09-09. Results received: No. Last updated: 2025-04-17.

Condition(s): Patients displaying a non-classified, severe and resistant inflammatory disease
Product: TOCILIZUMAB, SECUKINUMAB, ANAKINRA, ADALIMUMAB, RITUXIMAB, USTEKINUMAB

Primary endpoint: Response will be assessed at month 6 after treatment initiation with a composite endpoint defined as improvement of at least 2 of the 3 following parameters: - 50% improvement of the systemic activity assessed by the clinician following a visual analog scale (0-10), - and/or 50% improvement of cutaneous activity assessed by the involved skin surface area, - and/or 50% decrease or nomalisation of biological markers of inflammation (either CRP, ESR or fibrin)

Source: https://euclinicaltrials.eu/ctis-public/view/2024-513647-86-00